EU clinical trial 2024-511673-30-00: A superiority phase III study to compare the effect of Panzyga versus placebo in patients with pediatric acute-onset neuropsychiatric syndrome
Protocol code: NGAM-13
Sponsor: Octapharma Pharmazeutika Produktionsgesellschaft mbH (Pharmaceutical company). Phase: Therapeutic confirmatory (Phase III). Countries: Sweden (ended), Italy (ended).
Therapeutic area(s): Psychiatry and Psychology [F] - Behavioral Disciplines and Activities [F04]
Gender: Female, Male. Age: 0-17 years. Enrolment: 40.
Status: Ended. Start date (EU): 2023-03-20. End date (EU): 2024-10-30. End date: 2024-10-31. Decision date: 2024-05-02. Results received: Yes. Last updated: 2024-10-23.
Decision dates by country: IT: 2024-05-13, SE: 2024-05-02

Condition(s): Pediatric acute-onset neuropsychiatric syndrome (PANS)
Product: 0.9% w/v sodium chloride solution for intravenous infusion, Panzyga 100 mg/ml Infusionslösung

Primary endpoint: Improvement of neuropsychiatric symptomatology and behavior in PANS patients determined by clinician-rated CY-BOCS score. The mean changes in the total CY-BOCS score from Baseline to Week 9 will be compared between Panzyga and placebo treatment to demonstrate superiority.
Endpoint(s): 1. To assess the durability of the clinical benefit associated with Panzyga treatment, the CY-BOCS score at the end of the follow-up period at Week 18 will be compared to the Week 9 scores within the (Panzyga – Placebo) treatment sequence group to assess the durability of the clinical benefit associated with Panzyga treatment, 2. Clinical Global Impression (CGI), 3. Parent & Child OC Impact Scale – Revised (COIS-RP and COIS-RC), 4. The Swanson, Nolan, and Pelham Rating Scale (SNAP-IV, 26 item), 5. Parent Tic Questionnaire (PTQ)

Source: https://euclinicaltrials.eu/ctis-public/view/2024-511673-30-00